EU clinical trial 2024-517877-26-00: Perioperative hydrocortisone treatment in pancreatoduodenectomy – randomised double-blinded placebo-controlled interventional trial (PD-HYDRA)
Protocol code: P003623
Sponsor: Universitaetsklinikum Schleswig-Holstein AöR (Hospital/Clinic/Other health care facility). Phase: Phase II and Phase III (Integrated). Countries: Germany (ongoing, recruiting).
Therapeutic area(s): Diseases [C] - Digestive System Diseases [C06]
Gender: Female, Male. Age: 18-64 years, 65+ years. Enrolment: 614.
Status: Ongoing, recruiting. Start date (EU): 2025-10-16. Decision date: 2025-03-07. Results received: No. Last updated: 2026-07-13.

Condition(s): Pancreatic resection
Product: SODIUM CHLORIDE, HYDROCORTISON Pfizer 100 mg sine Pulver und Lösungsmittel zur Herstellung einer Injektions- oder Infusionslösung

Primary endpoint: 1. Post-operative pancreatic fistula of grade B or worse within 90 days after surgery (POPF B/C)
Endpoint(s): 2. POPF B/C within 90 days after pancreatoduodenectomy, 3. Overall survival within one year (OS), 4. Grade IIIb or worse complication in the Clavien-Dindo Classification (CDC) within 90 days after surgery (CDC IIIb+), 6. Grade C postpancreatectomy haemorrhage within 90 days after surgery (PPH C), 7. Grade B or worse delayed gastric emptying within 90 days after surgery (DGE B/C), 8. Grade B or worse bile leak within 90 days after surgery (BL B/C), 9. Grade B or worse chyle leak within 90 days after surgery (CL B/C), 10. Completion pancreatectomy within 90 days after surgery, 11. Surgical site infection within 90 days after surgery, 12. Pneumonia within 90 days after first dose, 13. Cholangitis within 90 days after first dose, (Serious) adverse events ((S)AE), 5. Grade B or worse postpancreatectomy acute pancreatitis within 90 days after surgery (PPAP B/C)

Source: https://euclinicaltrials.eu/ctis-public/view/2024-517877-26-00